EU clinical trial 2024-518797-13-00: The CALiPSO-1 Study: A Study of CNTY-101, a CD19-targeted CAR iNK Cell Product, in Participants with Refractory B cell-mediated Autoimmune Diseases
Protocol code: CNTY-101-151-01
Sponsor: Century Therapeutics Inc. (Pharmaceutical company). Phase: Human Pharmacology (Phase I)- Other. Countries: Italy (ended), Germany (ended), France (ended).
Therapeutic area(s): Diseases [C] - Immune System Diseases [C20]; Diseases [C] - Nervous System Diseases [C10]; Diseases [C] - Skin and Connective Tissue Diseases [C17]
Gender: Female, Male. Age: 18-64 years, 65+ years. Enrolment: 16.
Status: Ended. Start date (EU): 2025-07-10. End date (EU): 2026-05-06. End date: 2026-05-07. Decision date: 2025-04-16. Results received: No. Last updated: 2025-12-19.
Decision dates by country: IT: 2025-04-17, FR: 2025-04-22, DE: 2025-04-16

Condition(s): systemic lupus erythematosus [SLE]/lupus nephritis [LN], idiopathic inflammatory myopathy [IIM], and diffuse cutaneous systemic sclerosis [DcSSc]

Source: https://euclinicaltrials.eu/ctis-public/view/2024-518797-13-00